EU clinical trial 2022-500410-26-01: A Phase IIb, Multicentre, Randomised, Double-Blind, Placebo-Controlled, Crossover Study to Evaluate the Efficacy and Safety of Dirocaftor/Posenacaftor/Nesolicaftor in Subjects with Cystic Fibrosis Aged 18 Years or Older (CHOICES)
Protocol code: HIT-CF-001
Sponsor: University Medical Center Utrecht (Hospital/Clinic/Other health care facility). Phase: Therapeutic exploratory (Phase II). Countries: France (ended), Belgium (ended), Spain (ended), Sweden (ended), Czechia (ended), Portugal (ended), Netherlands (ended), Germany (ended), Italy (ended).
Therapeutic area(s): Diseases [C] - Respiratory Tract Diseases [C08]
Gender: Female, Male. Age: 18-64 years, 65+ years. Enrolment: 48.
Status: Ended. Start date (EU): 2024-05-27. End date (EU): 2025-05-28. End date: 2025-06-21. Decision date: 2024-04-30. Results received: Yes. Last updated: 2025-06-02.
Decision dates by country: IT: 2024-05-06, FR: 2024-05-03, SE: 2024-05-27, CZ: 2024-05-28, BE: 2024-05-03, ES: 2024-05-07, PT: 2024-04-30, NL: 2024-05-14, DE: 2024-05-14

Condition(s): Cystic Fibrosis
Product: Placebo for IMP PTI-428, Placebo for IMP PTI-808, PTI-801, Placebo for IMP PTI-801, PTI-428, PTI-808

Primary endpoint: The primary endpoint in both groups is the mean percent predicted forced expiratory volume in 1 second (ppFEV1) of measurements taken after 4, 6 and 8 weeks of treatment. Period baseline values will be corrected for in the analysis.
Endpoint(s): The average of the sweat chloride measurements taken after 4, 6 and 8 weeks of treatment, The average of the body weight measurements taken after 4, 6 and 8 weeks of treatment, The average of the Cystic Fibrosis Questionnaire Revised (CFQ R) respiratory domain measurements taken after 4, 6 and 8 weeks of treatment, Safety and tolerability assessments based on treatment-emergent Adverse Events (AEs) and Serious Adverse events (SAEs), clinical laboratory tests (ie, haematology, serum chemistry, coagulation studies, and urinalysis), physical examinations, electrocardiography (ECG), and vital signs, PK parameter estimates and metabolites of DIR/POS/NES derived from plasma

Source: https://euclinicaltrials.eu/ctis-public/view/2022-500410-26-01